EU clinical trial 2024-515456-20-00: Hepatocellular Carcinoma on Cirrhosis With Child A/B7 and Hepatic Intra Arterial Injection of Idarubicin/Lipiodol Emulsion : Phase II, single arm, Multicentric
Protocol code: LIDA-BII
Sponsor: Centre Hospitalier Universitaire De Montpellier (Hospital/Clinic/Other health care facility). Phase: Therapeutic exploratory (Phase II). Countries: France (ongoing, recruitment ended).
Therapeutic area(s): Diseases [C] - Neoplasms [C04]
Gender: Female, Male. Age: 18-64 years, 65+ years. Enrolment: 53.
Status: Ongoing, recruitment ended. Start date (EU): 2024-08-13. Decision date: 2024-08-13. Results received: No. Last updated: 2025-03-21.

Condition(s): Hepato carcinoma cancer
Product: LIPIODOL ULTRA FLUIDE 480 mg/ml, solution injectable, ZAVEDOS 10 mg, poudre pour solution pour perfusion

Primary endpoint: Disease control rate (partial, complete or stable response) at 4 months after the first cycle of chemo-lipiodol using mRECIST criteria.
Endpoint(s): Time until treatment failure defined as the time interval between the inclusion date and the date of treatment failure. Patients alive without treatment failure will be censored on the latest news date. Treatment failure is defined as progression, the appearance of toxicities, or the inability to administer chemotherapy., Progression-free survival: defined as the time interval between the date of inclusion and the date of first progression or death (whatever the cause). Patients living without progress will be censored on the date of the last news., The rate of patients in objective response (complete response or partial response) at 6 months to from the date of the first course of chemo-lipiodol according to the mRECIST criteria evaluated according to the investigator and centralized proofreading, Tolérance defined by the NCI CTC AE v4.03 scale., Quality of life questionnaire at 12 months after the first cycle of chemo-lipiodol at baseline, and 2, 4, 6, 12 months after the first cycle, The rate of thrombosis/hepatic arterial stenosis defined as the number of courses lasting which vascular thrombosis or stenosis is/are visible on arteriography initial hepatic artery(s), divided by the total number of cures., Overall survival defined as the time interval between the date of inclusion and the date of death (all causes). Patients alive without progression will be censored on the date of latest news.

Source: https://euclinicaltrials.eu/ctis-public/view/2024-515456-20-00